EU clinical trial 2023-508500-38-00: Sonographic Diagnostics with Oral Contrast for Crohn’s disease 2. A novel method for detecting Crohns disease using sonographic intraluminal contrast
Protocol code: Luminal Sonazoid 002
Sponsor: Helse Bergen HF (Hospital/Clinic/Other health care facility). Phase: Therapeutic exploratory (Phase II). Countries: Norway (ongoing, recruiting).
Therapeutic area(s): Diseases [C] - Digestive System Diseases [C06]
Gender: Female, Male. Age: 18-64 years, 65+ years. Enrolment: 104.
Status: Ongoing, recruiting. Start date (EU): 2025-09-12. Decision date: 2025-04-11. Results received: No. Last updated: 2025-04-11.

Condition(s): Crohn's disease
Product: Laxabon pulver til mikstur, oppløsning i doseposer a 68,5 g., Sonazoid 8 mikroliter per ml pulver og væske til injeksjonsvæske, dispersjon

Primary endpoint: Number of patients with homogenous contrast filling of the entire lumen of the terminal ileum within 1 hours of ingestion, with a clear separation between the lumen and intestinal wall as visually assessed by the examiner.
Endpoint(s): Number of patients who develop adverse events and severe adverse events, Number of patients who are willing to undergo the procedure again, Number of patients with detected stenosis in the terminal ileum with and without contrast, as visually assessed by the examiner and confirmed on endoscopy., Number of patients with detected ulcers >0,5cm in the terminal ileum with and without contrast, as visually assessed by the examiner and confirmed on endoscopy, Number of patients with large (0,5cm-2cm) and very large (>2cm) ulcers in the terminal ileum with and without contrast, as visually assessed by the examiner and confirmed on endoscopy., Interobserver variability for wall thickness in the terminal ileum with and without contrast as visually assessed by the examiner., Number of patients with visible intestinal contractions with and without contrast, Number of patients with ulcers and visible intestinal contractions in the terminal ileum, Number of patients with stenosis and visible intestinal contractions in the terminal ileum, The correlation between ulcer size, bowel wall thickness and frequency of contractions in the terminal ileum., The correlation of motility findings in Crohn’s patients and healthy volunteers, The number of patients with detected disease activity in the neoterminal ileum with and without contrast.

Source: https://euclinicaltrials.eu/ctis-public/view/2023-508500-38-00